EU clinical trial 2023-508895-13-00: A double-blind, randomized, placebo-controlled, multicentric, phase II study in adult patients with amyotrophic lateral sclerosis (ALS) to assess efficacy, safety, tolerability and pharmacokinetics of multiple intravenous infusions of NX210c.
Sponsor: Axoltis Pharma (Pharmaceutical company). Phase: Therapeutic exploratory (Phase II). Countries: France (ongoing, recruitment ended).
Therapeutic area(s): Diseases [C] - Musculoskeletal Diseases [C05]; Diseases [C] - Nervous System Diseases [C10]
Gender: Female, Male. Age: 18-64 years, 65+ years. Enrolment: 80.
Status: Ongoing, recruitment ended. Start date (EU): 2024-10-25. Decision date: 2024-03-29. Results received: No. Last updated: 2026-03-30.

Condition(s): Amyotrophic Lateral Sclerosis (ALS)
Product: NX210c, GLUCOSE 5 % B.BRAUN, solution pour perfusion

Primary endpoint: Changes in serum NfL from predose to 6-week follow-up OR Changes in Albumin CSF/serum quotient (Qalb) from predose to 6-week follow-up.
Endpoint(s): Changes in serum NfL from predose to 4-month follow-up or intervals from predose to 4-month follow-up., Changes in CSF NfL from predose to 6-week follow-up., Changes in secondary blood biomarkers from predose to 6-week or 4-month follow-up or intervals from predose to 4-month follow-up., Changes in secondary urine biomarkers from predose to 6-week or 4-month follow-up or intervals from predose to 4-month follow-up., Changes in secondary CSF biomarkers from predose to 6-week follow-up., Changes in Amyotrophic Lateral Sclerosis Functional Rating Scale – Revised (ALSFRS-R, subscores and total) from baseline to 4-month follow-up or intervals from baseline to 4-month follow-up., Changes in Slow Vital Capacity (SVC) from baseline to 4-month follow-up or intervals from baseline to 4-month follow-up., Changes in hand-held dynamometry (HHD) muscles and bilateral hand grip from baseline to 4-month follow-up or intervals from baseline to 4-month follow-up., Evaluate disease progression rate: Delta FS (ΔFS) from baseline to 4-month follow-up or intervals from baseline to 4-month follow-up., Evaluation of time from baseline to the occurrence of either death, or tracheotomy or permanent assisted ventilation (>22 hours daily for >7 consecutive days, hospitalization), or decrease in weight, whichever comes first., Recorded time from baseline to death., Changes in CAFS from baseline to 4-month follow-up or intervals from baseline to 4-month follow-up., Change in Amyotrophic Lateral Sclerosis Assessment Questionnaire (ALSAQ-40) from baseline to 4-month follow-up or intervals from baseline to 4-month follow-up., Secondary safety and tolerability endpoints: Incidence of discontinued treatment due to a treatment-emergent adverse event (TEAE), Incidence of dose decision required during the treatment period due to TEAE, Incidence of discontinued patient due to local tolerability issue(s), Incidence of dose decision required during the treatment period due to local tolerability issue., Number of serious adverse events (SAEs), nature, incidence, and severity of TEAEs: Incidence of abnormal vital signs, Incidence of abnormal 12-lead electrocardiogram (ECG) assessments, Incidence of abnormal laboratory tests (hematology, biochemistry, urinalysis)., Changes in physical and neurological examination., Assessment of NX210c plasma PK parameters: Cmax, Tmax, AUC0-last, AUC0-inf, T1/2, CL, Vz on a subset of patients.

Source: https://euclinicaltrials.eu/ctis-public/view/2023-508895-13-00